EU clinical trial 2024-519201-36-00: Investigator initiated clinical trial of dantrolene as a treatment for Darier disease
Sponsor: Karolinska University Hospital (Hospital/Clinic/Other health care facility). Phase: Therapeutic exploratory (Phase II). Countries: Sweden (ended).
Therapeutic area(s): Diseases [C] - Skin and Connective Tissue Diseases [C17]
Gender: Female, Male. Age: 18-64 years, 65+ years. Enrolment: 20.
Status: Ended. Start date (EU): 2024-11-07. End date (EU): 2025-09-10. Decision date: 2024-11-07. Results received: No. Last updated: 2024-11-07.

Condition(s): Darier disease
Product: Dantrium Capsules 25mg

Primary endpoint: The primary endpoint will be a reduction of skin area affected using the 5-point Physician Global Assessment (PGA) scale (23). A 20 % reduction (1 point) will be considered the minimal clinically important difference.
Endpoint(s): As the main secondary endpoint, improvement in dermatological quality of life index (DLQI) will be used. A 4 points improvement in DLQI will be considered the minimal clinically important difference (24). We will also examine mood with the Montgomery–Åsberg Depression Rating Scale (MADRS) and treatment satisfaction with the Treatment Satisfaction Questionnaire for Medication (TSQM)., As complementary skin assessment tools we will use the Eczema Area and Severity Index (EASI) scale and Body Surface Area (BSA)., Number of adverse events and adverse reactions, serious and non-serious.

Source: https://euclinicaltrials.eu/ctis-public/view/2024-519201-36-00